EU clinical trial 2023-507116-12-00: A Study to Learn if a Medicine That Reduces Stomach Acid Affects the Blood Level of Study Intervention Called Sisunatovir in Healthy Adults
Protocol code: C5241017
Sponsor: Pfizer Inc. (Pharmaceutical company). Phase: Human Pharmacology (Phase I)- Other. Countries: Belgium (ended).
Therapeutic area(s): Diseases [C] - Virus Diseases [C02]
Gender: Female, Male. Age: 18-64 years, 65+ years. Enrolment: 16.
Status: Ended. Start date (EU): 2023-10-25. End date (EU): 2024-07-19. End date: 2024-07-20. Decision date: 2023-10-11. Results received: No. Last updated: 2024-05-03.

Condition(s): RSV

Source: https://euclinicaltrials.eu/ctis-public/view/2023-507116-12-00